EU clinical trial 2024-517485-42-00: RESET-TRD; a Randomised trial on oral ESketamine compared to Electroconvulsive Therapy for patients with Treatment Resistant Depression
Sponsor: Universitair Medisch Centrum Groningen (Hospital/Clinic/Other health care facility). Phase: Therapeutic confirmatory (Phase III). Countries: Netherlands (authorised, recruitment pending).
Therapeutic area(s): Psychiatry and Psychology [F] - Mental Disorders [F03]
Gender: Female, Male. Age: 18-64 years, 65+ years. Enrolment: 172.
Status: Authorised, recruitment pending. Decision date: 2024-11-12. Results received: No. Last updated: 2024-11-12.

Condition(s): Non-psychotic therapy resistant unipolar depression
Product: Ketanest-S 25 Multi-dose, oplossing voor injectie 25 mg/ml

Primary endpoint: The primary objective of this trial is to compare the shortterm efficacy of oral esketamine versus ECT in patients with NTRD. In this regard, the percentage of treatment response, defined as a ≥30% reduction on the MADRS, in the esketamine relative to the ECT condition after eight weeks of treatment will be determined. Non-inferiority is defined as the esketamine arm having no less than 70% of the efficacy of ECT., In this regard, the percentage of relapse, defined as a <30% reduction, in the esketamine relative to the ECT condition after 12 months of maintenance treatment will be determined.

Source: https://euclinicaltrials.eu/ctis-public/view/2024-517485-42-00